EU clinical trial 2024-513446-12-00: An open, randomized-controlled, multi-center phase-II clinical trial of individualized immunosuppression with intravenously administered donor modified immune cells (MIC) compared to standard-of-care in living donor kidney transplantation
Protocol code: TOL-2
Sponsor: TolerogenixX GmbH (Pharmaceutical company). Phase: Therapeutic exploratory (Phase II). Countries: Germany (ongoing, recruitment ended).
Therapeutic area(s): Phenomena and Processes [G] - Immune system processes [G12]
Gender: Female, Male. Age: 18-64 years, 65+ years. Enrolment: 126.
Status: Ongoing, recruitment ended. Start date (EU): 2022-05-03. Decision date: 2024-07-23. Results received: No. Last updated: 2026-03-12.

Condition(s): Living donor kidney transplantation
Product: MIC

Primary endpoint: Proportion of patients who achieve an operational tolerance-like phenotype defined on Visit Day 367 as fulfilling all of the following criteria: 1. No acute rejection, graft loss, graft dysfunction or death; 2. No development of donor-specific HLA antibodies until Visit Day 367; 3. Induction of Breg ≥3% measured on Visit Day 367; 4. Patient on tacrolimus therapy with ≤720 mg ECMPS and no corticosteroids on Visit Day 277 and remaining on this therapy until Visit Day 367.
Endpoint(s): Key secondary: Number of patient-relevant infections during the first year after transplantation, Key secondary: Proportion of patients with acute rejection (biopsy-proven as >Banff Borderline or clinically suspected rejection according to evaluation of adjudication committee), graft loss, graft dysfunction or death on Visit Day 367, AEs including serious AEs and AEs of special interest, Frequency of local or systemic reactions as result of MIC application, Patient-, graft and death-censored graft survival, Incidence of biopsy-proven acute rejections and time to first rejection (>Banff Borderline) according to current version Banff criteria and confirmed by a blinded central pathologist, Molecular scores in molecular microscope diagnostic system (MMDx) reading on Visit Day 367, Percentage of patients who achieved tacrolimus and EC-MPS dual therapy (MIC Arm A, Control Arm) or tacrolimus monotherapy (MIC Arm B) on Visit Day 367, Development of donor-specific HLA-antibodies (>1,000 MFI; confirmed by second measurement after 4 weeks for assessments after Day 6) until Visit Days 6, 187 and 367, as measured by Luminex single antigen test, Occurrence of delayed function of the kidney graft after transplantation, defined as dialysis within the first week after transplantation, except for one dialysis for hyperkalemia, eGFR (according to chronic kidney disease epidemiology collaboration [CKD-EPI]), Incidence of CMV reactivation (CMV-DNA ≥1,000 copies/mL), Incidence of BK virus replication ≥1,000 copies/mL, Incidence of BK virus associated nephropathy, Incidence of hospital readmissions after transplant surgery, Days in hospital, on intensive care (ICU)/intermediate care (IMC) and hours on mechanical ventilation upon re-admission, Change of quality of life (SF-36) on Visit Day 367 compared to Baseline, Incidence of new-onset diabetes mellitus after transplantation (fasting plasma glucose ≥7.0 mmol/L / 126 mg/dL with no calorie intake for at least 8 hours), Therapeutic intensity score and blood pressure on Visit Day 367 compared to Baseline, Breg percentage, Anti-donor T cell response to the donor, Cumulative steroid dose until Visit Day 367

Source: https://euclinicaltrials.eu/ctis-public/view/2024-513446-12-00